EU clinical trial 2023-509988-24-00: Feasibility of short-term temporary discontinuation of serotonin reuptake inhibitors in patients planned for hip or knee arthroplasty
Sponsor: Sygehus Lillebaelt Vejle Sygehus (Hospital/Clinic/Other health care facility). Phase: Phase III and phase IV (Integrated). Countries: Denmark (not authorised).
Therapeutic area(s): Diseases [C] - Musculoskeletal Diseases [C05]
Gender: Female, Male. Age: 18-64 years, 65+ years. Enrolment: 100.
Status: Not authorised. Decision date: 2024-03-25. Results received: No. Last updated: 2024-03-25.

Condition(s): Hip and knee osteoarthritis
Product: DULOXETINE, SERTRALINE, PAROXETINE, ESCITALOPRAM, CITALOPRAM

Primary endpoint: The proportion of patients planned for THA/TKA/UKA in SSRI/SNRI therapy, who are able to discontinue SSRI/SNRI therapy perioperatively.
Endpoint(s): The proportions of patients planned for THA/TKA/UKA in SSRI/SNRI therapy, who opt out of the tapering of SSRI/SNRI therapy due to discontinuation syndrome, relapse of depression, relapse of anxiety or other reasons., The proportion of patients planned for THA/TKA/UKA in SSRI/SNRI therapy, who are not able to discontinue SSRI/SNRI therapy completely, but able to reduce their doses., Discontinuation-Emergent Signs and Symptoms (DESS), Major Depression Inventory (MDI) and Symptom Checklist 92 (SCL-92) score at baseline, after 2 weeks, the day before surgery (after 5 weeks) and 2 months after surgery., The proportion of patients planned for THA/TKA/UKA in SSRI/SNRI therapy, who uses SSRIs/SNRIs 2 months after surgery., The proportion of patients planned for THA/TKA/UKA in SSRI/SNRI therapy able to discontinue SSRI/SNRI therapy perioperatively who uses SSRIs/SNRIs 2 months after surgery.

Source: https://euclinicaltrials.eu/ctis-public/view/2023-509988-24-00